EU clinical trial 2025-520454-11-00: A study to investigate safety, tolerability, pharmacokinetics and efficacy of REM0045392 compared with placebo in healthy participants
Protocol code: REMAD-04
Sponsor: Remynd (Pharmaceutical company). Phase: Human Pharmacology (Phase I)- First administration to humans. Countries: Belgium (ended).
Therapeutic area(s): Diseases [C] - Nervous System Diseases [C10]
Gender: Female, Male. Age: 18-64 years, 65+ years. Enrolment: 72.
Status: Ended. Start date (EU): 2025-03-20. End date (EU): 2025-12-15. Decision date: 2025-03-07. Results received: No. Last updated: 2025-11-12.

Condition(s): Alzheimer

Source: https://euclinicaltrials.eu/ctis-public/view/2025-520454-11-00